EU clinical trial 2023-506365-64-00: A Phase 3 Randomized, Placebo-controlled, Double-blind Study of Niraparib in Combination with Abiraterone Acetate and Prednisone Versus Abiraterone Acetate and Prednisone for the Treatment of Participants with Deleterious Germline or Somatic Homologous Recombination Repair (HRR) Gene-Mutated Metastatic Castration-Sensitive Prostate Cancer (mCSPC)
Protocol code: 67652000PCR3002
Sponsor: Janssen - Cilag International (Pharmaceutical company). Phase: Therapeutic confirmatory (Phase III). Countries: Bulgaria (ongoing, recruitment ended), Czechia (ongoing, recruitment ended), Poland (ongoing, recruitment ended), Hungary (ongoing, recruitment ended), Sweden (ongoing, recruitment ended), Italy (ongoing, recruitment ended), Belgium (ongoing, recruitment ended), Netherlands (ongoing, recruitment ended), France (ongoing, recruitment ended), Spain (ongoing, recruitment ended), Denmark (ongoing, recruitment ended), Germany (ongoing, recruitment ended), Portugal (ongoing, recruitment ended).
Therapeutic area(s): Diseases [C] - Neoplasms [C04]
Gender: Male. Age: 18-64 years, 65+ years. Enrolment: 211.
Status: Ongoing, recruitment ended. Start date (EU): 2020-10-16. Decision date: 2024-03-28. Results received: No. Last updated: 2026-06-26.
Decision dates by country: CZ: 2024-04-02, NL: 2024-03-29, HU: 2024-04-02, SE: 2024-04-03, BG: 2024-04-15, FR: 2024-03-28, DE: 2024-04-03, IT: 2024-04-03, PT: 2024-04-01, BE: 2024-03-29, ES: 2024-04-01, PL: 2024-03-28, DK: 2024-04-02

Condition(s): Deleterious Germline or Somatic Homologous Recombination Repair (HRR) Gene-Mutated Metastatic Castration-Sensitive Prostate Cancer (mCSPC)
Product: RELUGOLIX, Placebo for ABIRATERONE ACETATE, Placebo for Niraparib, Placebo for NIRAPARIB / ABIRATERONE ACETATE 50/500 mg FDC, Prednison acis 5 mg, Tabletten, Niraparib tosylate monohydrate + abiraterone acetate - Film coated tablet- 79.90 mg (eq. 50mg base)+ 500mg, Placebo for NIRAPARIB / ABIRATERONE ACETATE 100/500 mg FDC, Niraparib, Niraparib - capsule - 100 mg, PREDNISOLONE, ABIRATERONE, DEGARELIX, TECHNETIUM (99MTC) COMPOUNDS, Niraparib tosylate monohydrate+ abiraterone acetate - Film coated tablet- 159.40 mg (eq. 100mg base)+ 500mg, Abiraterone acetate - tablet - 250 mg

Primary endpoint: Radiographic progression-free survival (rPFS)

Source: https://euclinicaltrials.eu/ctis-public/view/2023-506365-64-00